EU clinical trial 2023-507868-39-00: Evaluating, clinical and immunological effects of rituximab with cyclophosphamide compared to rituximab alone in AAV patients (The ENDURRANCE-1 Study)
Sponsor: Academisch Ziekenhuis Leiden (Hospital/Clinic/Other health care facility). Phase: Therapeutic use (Phase IV). Countries: Netherlands (ongoing, recruiting).
Therapeutic area(s): Diseases [C] - Immune System Diseases [C20]
Gender: Female, Male. Age: 18-64 years, 65+ years. Enrolment: 100.
Status: Ongoing, recruiting. Start date (EU): 2019-05-03. Decision date: 2024-08-22. Results received: No. Last updated: 2025-08-11.

Condition(s): ANCA Vasculitis
Product: Cyclophosphamide 500 mg Powder for Solution for Injection or Infusion, Truxima 500 mg concentrate for solution for infusion, Truxima 100 mg concentrate for solution for infusion

Primary endpoint: Compare the number of RTX retreatment infusions needed to maintain clinical remission over 2 years, based on B-cell status and ANCA status, in both arms
Endpoint(s): Assess the time to an ANCA negative test by using a high-quality ELISA measuring ANCAs. A negative test is defined as below the detection level, Assess the time to ANCA return defined as seroconversion to positive on at least 2 consecutive visits (the time of the first is then representative time of seroconversion) OR a doubling of the ANCA serum levels PR3 or MPO ELISA test compared to a previously achieved nadir, Duration of B-cell depletion defined as time taken to detect a repopulation of B-cells above the detection limit of standard flowcytometry (i.e. > 1x10^6 cells/L), To assess the safety parameters of each treatment arm including adverse events according to WHO toxicity criteria and recording of infectious events, To assess quality of life by patient related outcome scores (AAV-PRO and SNOT22), To assess clinical disease activity of each treatment arm as described in section 7.2.3 of the protocol

Source: https://euclinicaltrials.eu/ctis-public/view/2023-507868-39-00